EU clinical trial 2024-517467-23-00: Prevention of relapse with Levamisole as adjuvant therapy to corticosteroids in children with first episode of idiopathic nephrotic syndrome
Protocol code: NL61906.018.17
Sponsor: Amsterdam UMC Stichting (Hospital/Clinic/Other health care facility). Phase: Therapeutic confirmatory (Phase III). Countries: Netherlands (ongoing, recruitment ended).
Therapeutic area(s): Diseases [C] - Immune System Diseases [C20]
Gender: Female, Male. Age: 0-17 years. Enrolment: 87.
Status: Ongoing, recruitment ended. Start date (EU): 2024-11-29. Decision date: 2024-11-29. Results received: No. Last updated: 2024-11-29.

Condition(s): steroid sensitive idiopathic nephrotic syndrome
Product: ELMISOL 5, ELMISOL 25, ELMISOL 50, ELMISOL 10, the placebo has the same composition as the tested IMP with the exception of the active substance

Primary endpoint: The occurrence of relapses within 12 months after first presentation. A relapse is defined as the recurrence of proteinuria (3+ urine dipstick or proteinuria> 200 mg/mmol creatinine) for 3 consecutive days
Endpoint(s): Time to first relapse, Relapse rate (number of relapses per person year) over 2-year period, Cumulative steroid dosage up to 2 years, Occurrence of adverse events and treatment discontinuation, Proportion of frequent relapsers or steroid dependency over 2-year period, Toxicity of levamisole: Proportion of patients with elevated ASAT- /ALAT-levels (>3 times upper limit of normal), neutropenia (<1500/mm3) or positive ANCA., Toxicity of corticosteroids: Differences in BMI, blood pressure, height, weight, serum glucose between groups; Proportion of patients with overweight (BMI >25 kg/m2, hypertension (p>90), and hyperglycemia, Days of school missing, outpatient visits and hospitalization days (macro-economic analysis), Number of treatment interruptions

Source: https://euclinicaltrials.eu/ctis-public/view/2024-517467-23-00